EU clinical trial 2024-519344-32-00: A Phase Ib/II, multi-site, open-label, dose finding trial to evaluate the safety, efficacy, and pharmacokinetics of BNT326 in combination with BNT327 in participants with advanced non-small cell lung cancer (NSCLC)
Protocol code: BNT326-02
Sponsor: BioNTech SE (Pharmaceutical company). Phase: Phase I and Phase II (Integrated)- Other. Countries: Poland (ongoing, recruiting), Germany (ongoing, recruiting), Italy (ongoing, recruiting), Spain (ongoing, recruiting).
Therapeutic area(s): Diseases [C] - Neoplasms [C04]
Gender: Female, Male. Age: 18-64 years, 65+ years. Enrolment: 88.
Status: Ongoing, recruiting. Start date (EU): 2026-03-16. Decision date: 2025-12-02. Results received: No. Last updated: 2026-06-08.
Decision dates by country: ES: 2025-12-09, DE: 2025-12-08, PL: 2025-12-08, IT: 2025-12-02

Condition(s): Non-small Cell Lung Cancer
Product: PEMBROLIZUMAB, PACLITAXEL, BNT327 1-15, BNT327, CARBOPLATIN, PEMETREXED, BNT326

Primary endpoint: Part 1 - Occurrence of dose limiting toxicities (DLTs) within a participant during the DLT evaluation period, Part 1 and Part 2a - Occurrence of treatment emergent adverse events (TEAEs), treatment-related adverse events (TRAE), treatment emergent serious adverse events (TESAE), treatment-related serious adverse events (TRSAE), Part 1 and Part 2a - Occurrence of dose interruption, reduction, and discontinuation due to TEAEs, Part 2a and Part 2b - Objective response rate (ORR): Defined as the proportion of participants in whom a confirmed complete response (CR) or partial response (PR) is observed as best overall response.
Endpoint(s): Part 1 – ORR: Defined as the percentage of participants in whom a confirmed CR or PR (per RECIST v1.1 based on the investigator’s assessment) is observed as best overall response., Part 2b - Occurrence of TEAEs, TRAEs, TESAEs, TRSAEs, Part 2b - Occurrence of dose interruption, reduction, and discontinuation due to TEAEs, Part 2a and Part 2b - Progression free survival based on the investigator's assessment: Defined as the time from first dose of IMP to the first objective tumor progression or death from any cause, whichever occurs first., Part 2a and Part 2b - Disease control rate: Defined as the proportion of participants with CR, PR, or stable disease as best overall response., Part 2a and Part 2b - Duration of response: Defined as the time from first confirmed objective response (CR or PR per RECIST v1.1 based on the investigator’s assessment) to first occurrence of objective tumor progression or death from any cause, whichever occurs first, Part 2a and Part 2b - Time to response: Defined as the time from first dose of IMP to first confirmed objective response in participants with a confirmed objective response, Part 2a and Part 2b - Overall survival: Defined as the time from first dose of IMP to death from any cause, All cohorts - PK assessment: Maximum concentration derived from serum concentrations of BNT326 ADC, total anti-HER3 antibody component, and unconjugated payload. For applicable participants, if data permits., All cohorts - PK assessment: Time to reach maximum (peak) serum concentration derived from serum concentrations of BNT326 ADC, total anti-HER3 antibody component, and unconjugated payload. For applicable participants, if data permits., All cohorts - Anti-drug antibody (ADA) prevalence and ADA incidence. By cohort and combination treatment regimen for applicable participants.

Source: https://euclinicaltrials.eu/ctis-public/view/2024-519344-32-00